EU clinical trial 2022-501972-25-00: A Randomized, Phase 3, Double-Blind Study of Chemoradiotherapy With or Without Pembrolizumab for the Treatment of High-risk, Locally Advanced Cervical Cancer (KEYNOTE-A18 / ENGOT-cx11/GOG-3047)
Protocol code: MK-3475-A18
Sponsor: Merck Sharp & Dohme LLC (Pharmaceutical company). Phase: Therapeutic confirmatory (Phase III). Countries: Germany (ended), Norway (ended), Ireland (ended), Belgium (ended), Spain (ended), France (ended), Czechia (ended), Italy (ended), Sweden (ended), Hungary (ended), Austria (ended), Greece (ended).
Therapeutic area(s): Diseases [C] - Neoplasms [C04]
Gender: Female. Age: 18-64 years, 65+ years. Enrolment: 273.
Status: Ended. Start date (EU): 2020-04-06. End date (EU): 2026-01-21. End date: 2026-03-05. Decision date: 2024-05-24. Results received: No. Last updated: 2026-04-08.
Decision dates by country: FR: 2024-05-24, CZ: 2024-05-27, BE: 2024-05-24, DE: 2024-05-24, GR: 2024-08-01, HU: 2024-05-24, SE: 2024-05-24, AT: 2024-07-01, ES: 2024-05-24, IE: 2024-05-24, NO: 2024-05-24, IT: 2024-06-03

Condition(s): Locally Advanced Cervical Cancer
Product: Placebo to Pembrolizumab, CISPLATIN, KEYTRUDA 25 mg/mL concentrate for solution for infusion

Primary endpoint: Progression-Free Survival (PFS) Per Response Evaluation Criteria in Solid Tumors Version 1.1 (RECIST 1.1) as Assessed by the Investigator, Overall Survival (OS)
Endpoint(s): Progression-Free Survival (PFS) Per Response Evaluation Criteria in Solid Tumors Version 1.1 (RECIST 1.1) as Assessed by Blinded Independent Central Review (BICR), Progression-Free Survival (PFS) Per Response Evaluation Criteria in Solid Tumors Version 1.1 (RECIST 1.1) at Month 24 as Assessed by the Investigator, Progression-Free Survival (PFS) Per Response Evaluation Criteria in Solid Tumors Version 1.1 (RECIST 1.1) at Month 24 as Assessed by Blinded Independent Central Review (BICR), Overall Survival (OS) at Month 36, Complete Response (CR) Rate Per Response Evaluation Criteria In Solid Tumors Version 1.1 (RECIST 1.1) at Week 12 as Assessed by the Investigator, Complete Response (CR) Rate Per Response Evaluation Criteria In Solid Tumors Version 1.1 (RECIST 1.1) at Week 12 as Assessed by Blinded Independent Central Review (BICR), Objective Response Rate (ORR) Per Response Evaluation Criteria in Solid Tumors Version 1.1 (RECIST 1.1) as Assessed by the Investigator, Objective Response Rate (ORR) Per Response Evaluation Criteria in Solid Tumors Version 1.1 (RECIST 1.1) as Assessed by Blinded Independent Central Review (BICR), Progression-Free Survival (PFS) Per Response Evaluation Criteria in Solid Tumors Version 1.1 (RECIST 1.1) in Programmed Cell Death 1 Ligand 1 (PD-L1) Positive Participants as Assessed by the Investigator, Progression-Free Survival (PFS) Per Response Evaluation Criteria in Solid Tumors Version 1.1 (RECIST 1.1) in Programmed Cell Death 1 Ligand 1 (PD-L1) Positive Participants as Assessed by Blinded Independent Central Review (BICR), Overall Survival (OS) in Programmed Cell Death 1 Ligand 1 (PD-L1) Positive Participants as Assessed by the Investigator, Overall Survival (OS) in Programmed Cell Death 1 Ligand 1 (PD-L1) Positive Participants as Assessed by Blinded Independent Central Review (BICR), Progression-Free Survival (PFS) After Next-Line Treatment (PFS 2) Following Discontinuation of Study Treatment, Change from Baseline in European Organization for Research and Treatment of Cancer Quality of Life Questionnaire-Core 30 (EORTC QLQ-C30) Global Health Status Score, Change from Baseline in European Organization for Research and Treatment of Cancer Quality of Life Questionnaire-Core 30 (EORTC QLQ-C30) Physical Function Score, Change from Baseline in European Organization for Research and Treatment of Cancer Quality of Life Questionnaire Symptom Specific Scale for Cervical Cancer (EORTC QLQ-CX24) Score, Number of Participants Who Experience One or More Adverse Events (AEs), Number of Participants Who Discontinue Study Treatment Due to an Adverse Event (AE)

Source: https://euclinicaltrials.eu/ctis-public/view/2022-501972-25-00